EU clinical trial 2023-509847-29-00: Phase 1/2a Open-Label, Dose-Escalation, Multicenter, First in-Human, Consecutive-Cohort, Clinical Trial of BI-1808, a Monoclonal Antibody to Tumor Necrosis Factor Receptor 2 (TNFR2), as a Single Agent and in Combination with Pembrolizumab in Subjects with Advanced Malignancies
Protocol code: 19-BI-1808-01
Sponsor: BioInvent International AB (Pharmaceutical company). Phase: Phase I and Phase II (Integrated)- First administration to humans. Countries: Sweden (ongoing, recruiting), Denmark (ongoing, recruiting), Hungary (ongoing, recruiting), Spain (ongoing, recruiting).
Therapeutic area(s): Diseases [C] - Neoplasms [C04]
Gender: Female, Male. Age: 18-64 years, 65+ years. Enrolment: 141.
Status: Ongoing, recruiting. Start date (EU): 2020-04-09. Decision date: 2024-04-19. Results received: No. Last updated: 2026-05-04.
Decision dates by country: DK: 2024-04-19, HU: 2024-04-19, ES: 2025-08-08, SE: 2024-04-19

Condition(s): Advanced solid tumors
Product: BI-1808, KEYTRUDA 25 mg/mL concentrate for solution for infusion, Paclitaxel Bendalis 6 mg/ml Konzentrat zur Herstellung einer Infusionslösung, BI-1808

Primary endpoint: Phase 1:Adverse events (AEs) and serious adverse events (SAEs) (graded according to National Cancer Institute [NCI] Common Terminology Criteria for Adverse Events [CTCAE] version 5.0) or newer when applicable, clinically significant laboratory parameters and physical findings and their causality to BI1808, or BI 1808 in combination with pembrolizumab. Occurrence of dose-limiting toxicities (DLTs) of BI-1808 and in combination with pembrolizumab., Phase 2a: AEs and SAEs (graded according to CTCAE version 5.0 or newer when applicable, clinically significant laboratory parameters and physical findings and their causality to BI1808, or BI 1808 in combination with pembrolizumab or pembrolizumab and paclitaxel.
Endpoint(s): Standard PK parameters for BI-1808 (including, but not limited to approximations of area under the serum concentration-time curve [AUC], maximum concentration [Cmax], and terminal half life [t½]). Antidrug antibodies (ADA) response to BI 1808. TNFR2 receptor occupancy on CD14+ and/or CD16+ cells.

Source: https://euclinicaltrials.eu/ctis-public/view/2023-509847-29-00